EU clinical trial 2025-521352-38-00: STOP-HAE: A Phase 3, Randomized, Double-Blind, Placebo-Controlled Study of siRNA Targeting of Prekallikrein With ADX-324 in Participants With Hereditary Angioedema
Protocol code: ADX-324-301
Sponsor: Adarx Pharmaceuticals Inc. (Pharmaceutical company). Phase: Therapeutic confirmatory (Phase III). Countries: Belgium (ongoing, recruiting), Poland (ongoing, recruiting), Italy (ongoing, recruiting), Czechia (ongoing, recruiting), Hungary (ongoing, recruiting), Spain (ongoing, recruiting), Germany (authorised, recruiting), Croatia (ongoing, recruiting), France (authorised, recruiting), Bulgaria (ongoing, recruiting), Austria (ongoing, recruiting).
Therapeutic area(s): Diseases [C] - Immune System Diseases [C20]
Gender: Female, Male. Age: 18-64 years, 65+ years. Enrolment: 36.
Start date (EU): 2026-01-16. Decision date: 2025-10-22. Results received: No. Last updated: 2026-07-15.
Decision dates by country: IT: 2025-10-24, PL: 2025-10-26, BE: 2025-10-23, HR: 2025-10-24, HU: 2025-10-28, ES: 2025-10-23, BG: 2025-10-23, AT: 2025-10-27, DE: 2025-10-22, CZ: 2025-10-22, FR: 2025-10-24

Condition(s): Hereditary Angioedema
Product: ADX-324, Sterile normal saline (0.9% sodium chloride solution)

Primary endpoint: The time-normalized number of Investigator-confirmed HAE attacks (per month) from Study Day 22 to the Week 25 Visit for ADX 324 vs placebo.
Endpoint(s): The time-normalized number of Investigator-confirmed HAE attacks (per month) from Study Day 22 to the Week 25 Visit for ADX-324 vs placebo., The time-normalized number of Investigator-confirmed HAE attacks requiring acute HAE therapy (per month) from Study Day 22 to the Week 25 Visit for ADX-324 vs placebo., The time-normalized number of Investigator-confirmed HAE attacks requiring acute HAE therapy (per month) from Study Day 22 to the Week 25 Visit for ADX-324 vs placebo., The time-normalized number of moderate or severe Investigator confirmed HAE attacks (per month) from Study Day 22 to the Week 25 Visit for ADX-324 vs placebo., The time-normalized number of moderate or severe Investigator confirmed HAE attacks (per month) from Study Day 22 to the Week 25 Visit for ADX-324 vs placebo., The proportion of participants who have not experienced an Investigator-confirmed HAE attack (HAE attack-free) from Study Day 22 to the Week 25 Visit for ADX-324 vs placebo., The proportion of participants who have not experienced an Investigator-confirmed HAE attack (HAE attack-free) from Study Day 22 to the Week 25 Visit for ADX-324 vs placebo., The proportion of participants with a clinical response defined as a reduction from baseline (ie, Screening rate) in Investigator-confirmed HAE attack rate between Study Day 22 to the Week 25 Visit for ADX-324 vs placebo., The proportion of participants with a clinical response defined as a reduction from baseline (ie, Screening rate) in Investigator-confirmed HAE attack rate between Study Day 22 to the Week 25 Visit for ADX-324 vs placebo.

Source: https://euclinicaltrials.eu/ctis-public/view/2025-521352-38-00